EU clinical trial 2024-513706-56-00: A Phase 2a, open-label, randomized, controlled, multi-center, proof of concept study, to assess the efficacy, safety, and tolerability of VS-01 on top of standard of care, compared to standard of care alone, in adult patients with acute-on-chronic liver failure (ACLF)
Protocol code: VS01-IIa-01
Sponsor: Versantis AG (Pharmaceutical company). Phase: Therapeutic exploratory (Phase II). Countries: Germany (ended), Belgium (ended), Spain (ended), France (ended), Hungary (ended), Italy (ended).
Therapeutic area(s): Diseases [C] - Nutritional and Metabolic Diseases [C18]
Gender: Female, Male. Age: 18-64 years, 65+ years. Enrolment: 102.
Status: Ended. Start date (EU): 2023-03-22. End date (EU): 2025-10-15. End date: 2025-10-16. Decision date: 2024-05-29. Results received: No. Last updated: 2025-07-01.
Decision dates by country: HU: 2025-03-19, BE: 2024-05-29, FR: 2024-07-11, ES: 2024-05-30, IT: 2025-03-13, DE: 2024-05-29

Condition(s): Acute-on-chronic liver failure (ACLF) is characterized by hepatic and extrahepatic organ dysfunction and/or failure and highly activated systemic inflammation. It leads to an accumulation of different metabolites, interalias ammonia, which cannot be metabolized. Hyperammonemia leads to Hepatic Encephalopathy (HE). ACLF is a major cause of death in cirrhosis, with an approximately 50% mortality rate. The selected patient population is ACLF grade 1, 2 or 3a patients.
Product: VS-01

Primary endpoint: CLIF-C ACLF score at Day 7
Endpoint(s): Outcome a) 90 day – mortality; b) 28 day – mortality; c) Time to death through Day 90; d) Time to death through Day 28; e) Change in ACLF grade through/at Days 7 and 28: - Rate of ACLF resolution; - Time to ACLF resolution; - Rate of ≥ one ACLF grade regression; - Time to ≥ one ACLF grade regression; f) Transplant-free survival through/at Day 90; g) Transplant-free survival through/at Day 28, Safety a) Incidence rate, severity, and relationship to VS-01 of adverse drug reactions and serious adverse drug reactions.

Source: https://euclinicaltrials.eu/ctis-public/view/2024-513706-56-00